EU clinical trial 2023-506252-24-00: Perioperative methadone compared to placebo in elderly hip fracture patients – a randomized controlled trial. Phase two of the MetaHip trial
Sponsor: Sygehus Soenderjylland Soenderborg (Hospital/Clinic/Other health care facility). Phase: Phase III and phase IV (Integrated). Countries: Denmark (ended).
Therapeutic area(s): Analytical, Diagnostic and Therapeutic Techniques and Equipment [E] - Anesthesia and Analgesia [E03]
Gender: Female, Male. Age: 65+ years. Enrolment: 130.
Status: Ended. Start date (EU): 2023-11-07. End date (EU): 2025-02-21. Decision date: 2023-10-02. Results received: Yes. Last updated: 2023-10-02.

Condition(s): Hip fractures
Product: METHADONE, Natriumklorid 9 mg/ml "Fresenius Kabi", solvens til parenteralt brug

Primary endpoint: Daily consumption of opioids
Endpoint(s): Pain, Standing up, Mobility, Nausea or vomiting, Time to discharge, Need for an antidote, Delirium, Constipation

Source: https://euclinicaltrials.eu/ctis-public/view/2023-506252-24-00